EU clinical trial 2024-515884-69-00: A Global, Multicenter, Randomized, Open-label, Phase 3 Study of Sacituzumab Govitecan Versus Standard of Care (SOC) in Participants With Previously Treated Extensive Stage Small Cell Lung Cancer (ES-SCLC)
Protocol code: GS-US-600-6165
Sponsor: Gilead Sciences Inc. (Pharmaceutical company). Phase: Therapeutic confirmatory (Phase III). Countries: Belgium (ongoing, recruiting), Poland (ongoing, recruiting), Hungary (ended), Germany (ongoing, recruiting), Italy (ongoing, recruiting), Romania (ongoing, recruiting), Greece (ongoing, recruiting), Netherlands (ongoing, recruiting), France (ongoing, recruiting), Norway (ended), Spain (ongoing, recruiting).
Therapeutic area(s): Diseases [C] - Neoplasms [C04]
Gender: Female, Male. Age: 18-64 years, 65+ years. Enrolment: 254.
Start date (EU): 2025-07-16. Decision date: 2025-05-27. Results received: No. Last updated: 2026-04-28.
Decision dates by country: BE: 2025-05-27, FR: 2025-05-28, HU: 2025-05-29, IT: 2025-05-28, RO: 2025-05-28, NO: 2025-05-28, PL: 2025-06-01, NL: 2025-06-02, ES: 2025-06-02, DE: 2025-05-27, GR: 2025-05-29

Condition(s): Extensive Stage Small Cell Lung Cancer (ES-SCLC)
Product: HYCAMTIN 4 mg powder for concentrate for solution for infusion, Trodelvy 200 mg powder for concentrate for solution for infusion

Primary endpoint: ORR is defined as the percentage of participants who have achieved a complete response (CR) or partial response (PR) as assessed by BICR according to RECIST v1.1, OS is defined as length of time from randomization until the date of death from any cause
Endpoint(s): PFS is defined as the time from date of randomization until disease progression as assessed by BICR according to RECIST v1.1 or death from any cause, whichever comes first, DOR is defined as is measured from the time of first response (CR or PR) as assessed by BICR according to RECIST v1.1, until the date of first documented disease progression or death, whichever comes first, Time to first deterioration in shortness of breath, Time to first deterioration in physical functioning, Incidence of treatment-emergent adverse events (AEs) and clinical laboratory abnormalities

Source: https://euclinicaltrials.eu/ctis-public/view/2024-515884-69-00